EU clinical trial 2024-514984-24-00: Oral and Neuro-Penetrative Alternative Antibiotics for Patients with Syphilis
Protocol code: Trep-AB
Sponsor: Fundacion Fls De Lucha Contra El Sida Las Enfermedades Infecciosas Y La Promocion De La Salud Y La Ciencia (Patient organisation/association). Phase: Phase III and phase IV (Integrated). Countries: Spain (ended).
Therapeutic area(s): Diseases [C] - Bacterial Infections and Mycoses [C01]
Gender: Female, Male. Age: 18-64 years, 65+ years. Enrolment: 224.
Status: Ended. Start date (EU): 2021-10-07. End date (EU): 2026-03-16. End date: 2026-03-20. Decision date: 2024-09-23. Results received: No. Last updated: 2024-09-23.

Condition(s): Syphilis
Product: BENZATHINE BENZYLPENICILLIN, LINEZOLID

Primary endpoint: Measurement of clinical cure by the healing of primary syphilis lesions within 2 weeks and secondary syphilis lesions within 6 weeks (clinical cure) from treatment start., Assessment of serological cure by four-fold decline in RPR titer or seroreversion at 12, 24, and 48 weeks (serological cure) from treatment start., Assessment of recurrence by molecular methods of Treponema pallidum (T.p.) DNA to determine relapse or reinfection (molecular cure) within 48 weeks from treatment start.
Endpoint(s): Assessment of T.p. strains by genomic molecular methods in ulcer or mucosal lesion swabs from patients with primary or secondary syphilis, Assessment of T.p. strains by genomic molecular methods in plasma from patients with secondary or early latent syphilis., Assessment of T.p. strains by genomic molecular methods in oral swab/saliva from patients with secondary or early latent syphilis., Assessment of T.p. strains by genomic molecular methods in skin punch biopsy from patients with secondary syphilis (in a selected group of patients, Assessment of T.p. strains by genomic molecular methods in ear lobe scraping from patients with early latent syphilis (in a selected group of patients)., Assessment of T.p. strains by genomic molecular methods in CSF from patients with suspicion of neurosyphilis (in a selected group of patients, if lumbar puncture clinically indicated)., Comparative genomics between the “resistant” and sensitive T.p. strains to identify mutations that might be the resistance phenotype, Proportion of patients with adverse events (AEs) related to LZD treatment compared with standard BPG treatment in patients with early syphilis, Change of RPR titer at week 2 from treatment start.

Source: https://euclinicaltrials.eu/ctis-public/view/2024-514984-24-00